EU clinical trial 2023-509306-29-00: A Phase 1/2 Open-Label, Umbrella Platform Design Study to Evaluate the Safety and Efficacy of Investigational Agents in Combination With Standard of Care Treatments as the Second-Line Treatment of Participants With Advanced/Metastatic Gastroesophageal Adenocarcinoma: Substudy 06D
Protocol code: MK-3475-06D
Sponsor: Merck Sharp & Dohme LLC (Pharmaceutical company). Phase: Phase I and Phase II (Integrated)- Other. Countries: Germany (authorised, recruiting), Italy (ongoing, recruiting), Norway (ongoing, recruiting), France (ongoing, recruiting).
Therapeutic area(s): Diseases [C] - Neoplasms [C04]
Gender: Female, Male. Age: 18-64 years, 65+ years. Enrolment: 57.
Start date (EU): 2024-09-26. Decision date: 2024-08-13. Results received: No. Last updated: 2026-04-17.
Decision dates by country: NO: 2024-08-13, FR: 2024-08-14, IT: 2024-08-13, DE: 2024-08-13

Condition(s): Gastroesophageal cancer
Product: PACLITAXEL, MK-2870, MK-1022, RAMUCIRUMAB, MK-2870, PARACETAMOL

Primary endpoint: Percentage of Participants with a Dose-Limiting Toxicity (DLTs) During the Safety Lead-In Phase, Percentage of Participants with an Adverse Event (AE) During the Safety Lead-In Phase, Percentage of Participants Who Discontinue Study Intervention Due to an AE During the Safety Lead-In Phase, Objective Response Rate (ORR)
Endpoint(s): Progression Free Survival (PFS), Duration of Response (DOR), Overall Survival (OS), Percentage of Participants Who Experience an AE During the Efficacy Phase, Percentage of Participants Who Discontinue Study Intervention Due to an AE During the Efficacy Phase, Incidence of sacituzumab tirumotecan anti-drug antibodies (ADAs), Incidence of HER3_DXd ADAs

Source: https://euclinicaltrials.eu/ctis-public/view/2023-509306-29-00